EU clinical trial 2022-501518-67-00: SUrGery with or without dARolutamide in high-risk and/or locally advanced prostate cancer
Protocol code: 22GENH03
Sponsor: Oncopole Claudius Regaud (Hospital/Clinic/Other health care facility). Phase: Therapeutic exploratory (Phase II). Countries: France (ongoing, recruitment ended).
Therapeutic area(s): Diseases [C] - Neoplasms [C04]
Gender: Male. Age: 18-64 years, 65+ years. Enrolment: 240.
Status: Ongoing, recruitment ended. Start date (EU): 2023-08-10. Decision date: 2023-03-24. Results received: No. Last updated: 2026-04-15.

Condition(s): High-risk and/or locally advanced prostate cancer
Product: BAY 1841788

Primary endpoint: The primary endpoint is the non-curable progression-free survival (NC-PFS). NC-PFS is defined as the time from randomization to non-curable event. At the time of analysis, patients alive without non-curable event will be censored at the last disease assessment. Patients alive without non-curable event who started a new anticancer therapy (except salvage or adjuvant pelvic radiotherapy and long-term ADT) will be censored at the last disease assessment prior to the start of the new therapy.
Endpoint(s): MFS is defined as the time from randomization to the appearance of distant metastasis or death from any cause (all other events will be ignored). At the time of analysis, patients alive without distant metastasis will be censored at the last disease assessment. Patients alive without distant metastasis who started a new anticancer therapy (except salvage or adjuvant pelvic radiotherapy) will be censored at the last disease assessment prior to the start of the new anticancer therapy., PSA-Recurrence-Free Survival (RFS) is defined as the time from randomization to PSA recurrence according to EAU criteria or death from any cause. At the time of analysis, patients alive without PSA recurrence will be censored at the last PSA assessment. Patients alive without PSA recurrence who started a new anticancer therapy will be censored at the last PSA assessment prior to the start of the new anticancer therapy., Overall Survival is defined as the time from randomization to death from any cause. At the time of analysis, patients alive will be censored at the last known alive date., pathological Complete Response rate is defined as the number of patients presenting a pathological complete response (i.e., absence of residual tumor found in the surgery specimens) divided by the number of patients in the experimental arm., Safety will be assessed using the NCI-CTCAE Version 5.0., Quality of life will be evaluated using the following questionnaire: - Functional Assessment of Cancer Therapy-Prostate (FACT-P) - EQ5D-5L - International Prostate Symptom Score (IPSS) - International Index of Erectile Function (IIEF-15)

Source: https://euclinicaltrials.eu/ctis-public/view/2022-501518-67-00